EU clinical trial 2024-515466-13-00: A Phase 1 Safety and Dose Finding Study of 131I -TLX101 Plus Standard of Care in Patients with Newly Diagnosed Glioblastoma
Protocol code: 131I-TLX-101-002
Sponsor: Telix Pharmaceuticals (Innovations) Pty Limited (Pharmaceutical company). Phase: Human Pharmacology (Phase I)- Other. Countries: Austria (ongoing, recruitment ended), Netherlands (ongoing, recruitment ended).
Therapeutic area(s): Diseases [C] - Neoplasms [C04]
Gender: Female, Male. Age: 18-64 years, 65+ years. Enrolment: 6.
Status: Ongoing, recruitment ended. Start date (EU): 2023-06-28. Decision date: 2024-09-08. Results received: No. Last updated: 2026-06-24.
Decision dates by country: NL: 2024-09-10, AT: 2024-09-08

Condition(s): Glioblastoma multiforme (GBM)

Source: https://euclinicaltrials.eu/ctis-public/view/2024-515466-13-00